EU clinical trial 2026-525669-33-00: Botulinum toxin A in the Treatment of Chronic Postsurgical Pain in Lung Cancer Patients: A feasibility study
Protocol code: BTX-CPSP
Sponsor: Aalborg University Hospital (Hospital/Clinic/Other health care facility). Phase: Therapeutic exploratory (Phase II). Countries: Denmark (authorised, recruitment pending).
Therapeutic area(s): Analytical, Diagnostic and Therapeutic Techniques and Equipment [E] - Therapeutics [E02]
Gender: Female, Male. Age: 18-64 years, 65+ years. Enrolment: 15.
Status: Authorised, recruitment pending. Decision date: 2026-08-01. Results received: No. Last updated: 2026-08-01.

Condition(s): Chronic postsurgical pain (CPSP)
Product: Xeomin, pulver til injektionsvæske, opløsning 100 enheder

Primary endpoint: Inclusion of a minimum of 15 participants within the study period., Determination of percentage of patients eligible for recruitment who are enrolled and the rate of enrolment., Recording of reasons for declining study participation, if possible., Determination of percentage of completion.
Endpoint(s): Testing of practical feasibility of the administration method by subcutaneous BTX-A injections in the chest wall evaluated by the percentages of participants completing the intended intervention., Evaluation of tolerability of the intervention during administration and possible side effects/adverse events during follow-up., Determination of questionnaire completion and participation rates at each follow-up assessment time point., Evaluation of “proof of concept” for subcutaneous BTX-A as pain relief in chronic postsurgical pain following surgery for lung cancer, specifically.

Source: https://euclinicaltrials.eu/ctis-public/view/2026-525669-33-00